EU clinical trial 2024-519515-34-00: L-Thyroxine for the treatment of acute unilateral vestibulopathy (AUVP): a monocentric, double-blind, placebo-controlled trial (T4U)
Protocol code: T4U-LMU-2026
Sponsor: Klinikum der Universitaet Muenchen AöR (Hospital/Clinic/Other health care facility). Phase: Therapeutic exploratory (Phase II). Countries: Germany (authorised, recruitment pending).
Therapeutic area(s): Diseases [C] - Nervous System Diseases [C10]
Gender: Female, Male. Age: 18-64 years, 65+ years. Enrolment: 48.
Status: Authorised, recruitment pending. Decision date: 2026-04-02. Results received: No. Last updated: 2026-04-02.

Condition(s): Patients with acute unilateral vestibulopathy (AUVP)
Product: P-Tabletten weiß 7 mm Lichtenstein, L-Thyroxin beta 200 μg Tabletten

Primary endpoint: Disease-related quality of life assessed by the change of the DHI value between inclusion and day 14 post study inclusion.
Endpoint(s): Disease-related quality of life assessed by change of the DHI value between inclusion and day 7, 45, 60, 90 and 180 post study inclusion, Health-related quality of life (assessed by EQ-5D-5L) at day 7, 14, 45, 60, 90, and 180 post study inclusion., Slow-phase velocity (SPV) of spontaneous nystagmus at day 7, 45, and 180 days after study inclusion, Total postural sway (with eyes closed) at day 7, 45, and 180 post study inclusion, Rate of conversion to secondary functional dizziness at day 180 post study inclusion

Source: https://euclinicaltrials.eu/ctis-public/view/2024-519515-34-00